EU clinical trial 2022-501645-70-00: A Phase 3, Multicenter, Randomized, Efficacy Assessor-Blinded Study of Risankizumab Compared to Ustekinumab for the Treatment of Adult Subjects With Moderate to Severe Crohn's Disease Who Have Failed Anti-TNF therapy
Protocol code: M20-259
Sponsor: Abbvie Deutschland GmbH & Co. KG (Pharmaceutical company). Phase: Therapeutic confirmatory (Phase III). Countries: Germany (ongoing, recruitment ended), France (ongoing, recruitment ended), Italy (ongoing, recruitment ended), Slovakia (ongoing, recruitment ended), Hungary (ongoing, recruitment ended), Netherlands (ended), Bulgaria (ongoing, recruitment ended), Austria (ongoing, recruitment ended), Poland (ongoing, recruitment ended), Greece (ongoing, recruitment ended), Belgium (ongoing, recruitment ended), Spain (ongoing, recruitment ended), Romania (ongoing, recruitment ended), Czechia (ongoing, recruitment ended).
Therapeutic area(s): Diseases [C] - Digestive System Diseases [C06]
Gender: Female, Male. Age: 18-64 years, 65+ years. Enrolment: 196.
Start date (EU): 2020-11-25. Decision date: 2023-06-06. Results received: No. Last updated: 2026-07-02.
Decision dates by country: NL: 2023-06-06, AT: 2023-06-13, BE: 2023-06-07, BG: 2023-06-12, CZ: 2023-06-12, FR: 2023-06-08, DE: 2023-06-07, HU: 2023-06-07, IT: 2023-06-09, RO: 2023-06-08, ES: 2023-06-09, SK: 2023-06-07, GR: 2023-06-07, PL: 2023-06-13

Condition(s): Crohns Disease
Product: Risankizumab, STELARA 130 mg concentrate for solution for infusion, ABBV-066, STELARA 90 mg solution for injection in pre-filled syringe, Risankizumab, ABBV-066 / Risankizumab

Primary endpoint: Part 1: Clinical remission (non-inferiority) at Week 24: CDAI < 150, Part 1: Endoscopic remission (superiority) at Week 48: defined as Simple Endoscopic Score for Crohn's Disease (SES-CD) ≤ 4 and at least a 2-point reduction versus Baseline and no sub score greater than 1 in any individual variable, as scored by a central reviewer, Part 2: Evaluation of long-term safety
Endpoint(s): Achievement of clinical remission (CDA < 150) at Week 48: superiority of risankizumab vs. ustekinumab., Achievement of endoscopic response at Week 48, superiority of risankizumab vs. ustekinumab, Achievement of endoscopic response at Week 24, superiority of risankizumab vs. ustekinumab, Achievement of steroid-free endoscopic remission Week 48, superiority of risankizumab vs. ustekinumab, Achievement of steroid-free clinical remission at Week 48, superiority of risankizumab vs. ustekinumab.

Source: https://euclinicaltrials.eu/ctis-public/view/2022-501645-70-00